EU clinical trial 2025-522960-34-00: ZENITH: A Phase 3 Global, Randomized, Double-blind, Placebo-controlled Study to Evaluate the Efficacy and Safety of Zilebesiran in Addition to Standard of Care in Reducing Major Adverse Cardiovascular Events in Adult Patients with Hypertension Not Adequately Controlled and With Either Established Cardiovascular Disease or High Risk for Cardiovascular Disease
Protocol code: ALN-AGT01-008
Sponsor: Alnylam Pharmaceuticals Inc. (Pharmaceutical company). Phase: Therapeutic confirmatory (Phase III). Countries: Belgium (ongoing, recruiting), Hungary (ongoing, recruiting), Czechia (ongoing, recruiting), Austria (ongoing, recruiting), Germany (ongoing, recruiting), France (ongoing, recruiting), Greece (ongoing, recruiting), Spain (ongoing, recruiting), Romania (ongoing, recruiting), Netherlands (ongoing, recruiting), Italy (ongoing, recruiting), Poland (ongoing, recruiting), Slovakia (ongoing, recruiting), Sweden (ongoing, recruiting), Portugal (ongoing, recruiting), Denmark (ongoing, recruiting), Bulgaria (ongoing, recruiting).
Therapeutic area(s): Diseases [C] - Cardiovascular Diseases [C14]
Gender: Female, Male. Age: 18-64 years, 65+ years. Enrolment: 3980.
Status: Ongoing, recruiting. Start date (EU): 2026-02-09. Decision date: 2026-02-03. Results received: No. Last updated: 2026-07-24.
Decision dates by country: AT: 2026-02-07, BE: 2026-02-04, BG: 2026-02-09, FR: 2026-02-04, GR: 2026-02-05, PT: 2026-02-05, RO: 2026-02-09, SK: 2026-02-03, SE: 2026-02-04, CZ: 2026-02-03, DE: 2026-02-04, HU: 2026-02-05, IT: 2026-02-06, PL: 2026-02-08, NL: 2026-02-04, ES: 2026-02-09, DK: 2026-02-03

Condition(s): Hypertension, High cardiovascular risk, Established cardiovascular disease
Product: 0.9% (w/v) sodium chloride with 5 mM phosphate buffered solution, Zilebesiran

Primary endpoint: 01. Time to first occurrence of a composite endpoint of CV death, nonfatal MI, nonfatal stroke, or HF event (hospitalization for HF or urgent HF visit).
Endpoint(s): 01. Change from baseline in mean seated office SBP at Month 6, 02. Time to first occurrence of a composite endpoint of CV death, nonfatal MI, or nonfatal stroke, 03. Composite endpoint of CV death and total (first and subsequent) HF events (hospitalization for HF or urgent HF visit), 04. Time to first occurrence of composite endpoint of CV death, nonfatal MI, nonfatal stroke, or coronary revascularization, 05. Time to all-cause death

Source: https://euclinicaltrials.eu/ctis-public/view/2025-522960-34-00